EU clinical trial 2024-518047-37-01: PRECISER; Prediction of ECT treatment response and reduction of Cognitive Side-effects using EEG and Rivastigmine
Protocol code: 202000842
Sponsor: Universitair Medisch Centrum Groningen (Hospital/Clinic/Other health care facility). Phase: Therapeutic use (Phase IV). Countries: Netherlands (ended).
Therapeutic area(s): Psychiatry and Psychology [F] - Mental Disorders [F03]
Gender: Female, Male. Age: 18-64 years. Enrolment: 100.
Status: Ended. End date (EU): 2025-06-03. Decision date: 2024-12-16. Results received: No. Last updated: 2024-12-16.

Condition(s): Depression
Product: RIVASTIGMINE, Rivastigmin adhesive plaster 9.5 mg placebo containing 0 mg of rivastigmin, Rivastigmin adhesive plaster 4.6 mg placebo containing 0 mg of rivastigmin, RIVASTIGMINE

Primary endpoint: No change in the rivastigmine group on cognitive and memory related measures (compared to an effect in the placebo group): significant interaction term between placebo and rivastigmine AND non-significant comparison on cognition and memory measures in the rivastigmine group between the timepoints (versus significant difference in the placebo group): at p <0.05, Classification algorithm for ECT response: accurate and statistically significant at p<0.05, Classification algorithm for side effects: accurate and statistically significant at p<0.05
Endpoint(s): To investigate quality of life related measures after rivastigmine addition: significant for the different measures at p<0.05, To investigate whether free speech is predictive of the antidepressant effects: classification (significant at p<0.05) AND significant (non)linear modelling at p<0.05, To investigate whether EEG could predict cognitive impairment: accurate and statistically significant at p<0.05, To investigate how network related measures change during an ECT course: statistically significant change between timepoints (p<0.05), To investigate how blood and DNA methylation change during ECT (or are predictive): p<0.05, To develop a comprehensive prediction method based on the available parameters: statistically significant change between timepoints (p<0.05), To investigate subjective measures of (anticipation) of response and side effects: p < 0.05

Source: https://euclinicaltrials.eu/ctis-public/view/2024-518047-37-01